EU clinical trial 2023-506270-13-00: A pivotal Phase II randomised, multi-centre, open-label study to evaluate the efficacy and safety of MB-CART2019.1 compared to standard of care therapy in participants with relapsed/refractory diffuse large B-cell lymphoma (R-R DLBCL), who are not eligible for high-dose chemotherapy and autologous stem cell transplantation
Protocol code: M-2020-371
Sponsor: Miltenyi Biomedicine GmbH (Pharmaceutical company). Phase: Therapeutic exploratory (Phase II). Countries: Belgium (ongoing, recruiting), Lithuania (ended), Poland (ongoing, recruitment ended), Hungary (ongoing, recruiting), Czechia (ongoing, recruiting), Italy (ongoing, recruiting), Netherlands (ongoing, recruiting), Spain (ongoing, recruiting), Germany (ongoing, recruiting), Austria (ongoing, recruiting), Sweden (ended), France (ongoing, recruiting), Croatia (authorised, recruiting), Finland (authorised, recruiting), Portugal (ended).
Therapeutic area(s): Diseases [C] - Neoplasms [C04]
Gender: Female, Male. Age: 18-64 years, 65+ years. Enrolment: 223.
Start date (EU): 2021-07-27. Decision date: 2024-02-19. Results received: No. Last updated: 2026-04-23.
Decision dates by country: SE: 2024-02-19, LT: 2024-02-21, AT: 2024-02-23, CZ: 2024-02-20, PL: 2024-02-20, ES: 2024-02-21, NL: 2024-02-19, IT: 2024-02-19, DE: 2024-02-20, HU: 2024-02-19, PT: 2026-01-29, BE: 2024-02-19, FR: 2024-02-20, HR: 2026-03-20, FI: 2026-03-05

Condition(s): Relapsed/refractory diffuse large B cell lymphoma (R-R DLBCL)
Product: GEMCITABINE, CYCLOPHOSPHAMIDE, POLATUZUMAB VEDOTIN, MB-CART2019.1, FLUDARABINE, TOCILIZUMAB, BENDAMUSTINE, RITUXIMAB, OXALIPLATIN

Primary endpoint: Part I: Event-free survival (EFS), defined as the time between the date of randomisation and the date of objective disease progression, failure to achieve partial response (PR) or complete response (CR) at or beyond Week 8 after randomisation leading to a new anti-lymphoma therapy or death of any cause, whichever occurs first, based on independent review committee (IRC) assessment., Part II: Best objective response rate (BORR), defined as the proportion of participants with at least one CR or PR between the date of MB-CART2019.1 infusion and the date of objective disease progression, the start of new antilymphoma therapy or the date of death from any cause, whichever occurs first, based on IRC assessment
Endpoint(s): Part I: Progression-free survival (PFS), defined as the time between the date of randomisation and the date of objective disease progression or death of any cause, whichever occurs first, based on IRC assessment., Part I: Best complete response rate (BCRR), defined as the proportion of participants with at least one CR assessment until Week 24 in the MB-CART2019.1 arm and Week 26 in the comparator arm based on IRC assessment., Part I: Duration of complete response (DOCR), defined as the time between the date of a first CR and the date of assessment of objective disease progression or the date of death of any cause, whichever occurs first, based on IRC assessment., Part I: Overall survival (OS), defined as time between the date of randomisation and the date of death of any cause., Part II: DOR, defined as the time between the date of a first objective response (CR/PR) after MB-CART2019.1 infusion and the date of assessment of objective disease progression or the date of death of any cause, whichever occurs first, based on IRC assessment and based on investigator assessment., Part II: PFS, defined as the time between the date of leukapheresis and the date of objective disease progression or death of any cause, whichever occurs first, based on IRC assessment and based on investigator assessment, Part II: PFS rates at 6 and at 12 months based on investigator assessment and based on IRC assessment., Part II: OS, defined as time between the date of leukapheresis and the date of death of any cause., Part II: BCRR, defined as the proportion of participants with CR between the date of MB-CART2019.1 infusion and the date of objective disease progression, the start of new anti-lymphoma therapy or the date of death from any cause, whichever occurs first based on IRC assessment and based on investigator assessment, Part II: DOCR, defined as the time between the date of a first CR and the date of assessment of objective disease progression or the date of death of any cause, whichever occurs first based on IRC assessment and based on investigator assessment, Part II: BORR based on investigator assessment., Part II: Changes in HRQoL, Part II: Changes in lymphoma symptoms, Part II: Persistence of MB-CART2019.1 and phenotype of immune cell compositions based on flow cytometry analyses and real time quantitative polymerase chain reaction (qPCR)., Part II: Types and levels of cytokines (sIL-2R, IL-6, IL-10, IL-15, IFN-ʏ and TNFα)., Part II: Anti-MB-CART2019.1 antibody, Part II: Type, frequency and severity of AEs, SAEs, and AESIs., Part II: Hospital days within 7 months after leukapheresis, Part II: ICU admission days within 7 months after leukapheresis., Part II: Use of tocilizumab and/or high-dose steroids, Part II: Need for transfusions, prophylactic antimicrobial therapy, and gamma globulin substitution within 12 months after leukapheresis.

Source: https://euclinicaltrials.eu/ctis-public/view/2023-506270-13-00